EU clinical trial 2025-522203-23-00: A Phase 1/2a, First-in-human, Open label Study of BMS-986517 as Monotherapy in Adult Participants with Advanced Solid Tumors
Protocol code: CA2540001
Sponsor: Bristol-Myers Squibb Services Unlimited Company (Pharmaceutical company). Phase: Phase I and Phase II (Integrated)- First administration to humans. Countries: Denmark (ongoing, recruiting), Spain (ongoing, recruiting).
Therapeutic area(s): Diseases [C] - Neoplasms [C04]
Gender: Female, Male. Age: 18-64 years, 65+ years. Enrolment: 29.
Status: Ongoing, recruiting. Start date (EU): 2025-12-18. Decision date: 2025-11-07. Results received: No. Last updated: 2026-03-27.
Decision dates by country: DK: 2025-11-07, ES: 2026-03-27

Condition(s): Advanced Solid Tumors
Product: BMS-986517

Primary endpoint: To monitor how often side effects that meet specific criteria (known as Dose Limiting Toxicities, DLTs) happen during the first 21 days from the first dose and how often side effects, serious side effects, DLTs, side effects causing treatment to stop, or deaths happen until 30 days after the last treatment.
Endpoint(s): To track whether participants’ tumors shrink and how long such responses last, as judged by study doctors, up to 3 years from the first treatment and monitor how BMS-986517 and its main components move through and are processed by the body up to 30 days after the last treatment.

Source: https://euclinicaltrials.eu/ctis-public/view/2025-522203-23-00